EU clinical trial 2022-502669-14-00: A Randomized, Open-label, Phase 3 Study of Tarlatamab Compared With Standard of Care in Subjects With Relapsed Small Cell Lung Cancer After Platinum-based First-line Chemotherapy (DeLLphi-304)
Protocol code: 20210004
Sponsor: Amgen Inc. (Pharmaceutical company). Phase: Therapeutic confirmatory (Phase III). Countries: Greece (ongoing, recruitment ended), Austria (ongoing, recruitment ended), Denmark (ongoing, recruitment ended), Czechia (ended), Spain (ongoing, recruitment ended), Romania (ongoing, recruitment ended), Hungary (ended), Portugal (ongoing, recruitment ended), France (ongoing, recruitment ended), Netherlands (ended), Italy (ongoing, recruitment ended), Germany (ongoing, recruitment ended), Belgium (ended), Ireland (ended), Poland (ongoing, recruitment ended).
Therapeutic area(s): Diseases [C] - Neoplasms [C04]
Gender: Female, Male. Age: 18-64 years, 65+ years. Enrolment: 199.
Start date (EU): 2023-12-18. Decision date: 2023-06-30. Results received: No. Last updated: 2026-07-17.
Decision dates by country: HU: 2023-06-30, BE: 2023-06-30, CZ: 2023-06-30, IT: 2023-07-04, IE: 2023-06-30, PL: 2023-07-05, DE: 2023-06-30, PT: 2023-06-30, AT: 2023-07-03, NL: 2023-07-04, FR: 2023-06-30, GR: 2023-06-30, ES: 2023-06-30, RO: 2023-06-30, DK: 2023-06-30

Condition(s): Small cell lung cancer (SCLC)
Product: Tarlatamab, TOCILIZUMAB, ELECTROLYTES, TOPOTECAN, TOPOTECAN, TOPOTECAN, Tarlatamab, DEXAMETHASONE, SILTUXIMAB, TOPOTECAN

Primary endpoint: Overall Survival is defined as the length of time from start of treatment (tarlatamab or Standard Of Care) for the disease until death, due to any cause
Endpoint(s): The length of time the participants are grouped to receive either tarlatamab or Standard Of Care by chance until the disease has progressed or resulted in death, Change from Baseline PROs assessed 6-weekly over time to 18 weeks for Chest Pain, cough as measured by EORTC-QLQ-LC13; Tightening in the chest as measured by EORTC-QLQ-C30 and EORTC-QLQ-LC13; and Physical Function and Global Health Status of life as measured by EORTC-QLQ-C30

Source: https://euclinicaltrials.eu/ctis-public/view/2022-502669-14-00